EU clinical trial 2024-519301-36-00: A study to test different doses of BI 765049 in people with advanced cancer of the colon, rectum, stomach, or pancreas
Protocol code: 1454-0015
Sponsor: Boehringer Ingelheim International GmbH, Boehringer Ingelheim Espana S.A. (Pharmaceutical company). Phase: Human Pharmacology (Phase I)- Other. Countries: Spain (ended), Germany (ended).
Therapeutic area(s): Diseases [C] - Neoplasms [C04]
Gender: Female, Male. Age: 18-64 years, 65+ years. Enrolment: 40.
Status: Ended. Start date (EU): 2025-07-11. End date (EU): 2026-07-03. Decision date: 2025-06-18. Results received: No. Last updated: 2025-07-18.
Decision dates by country: DE: 2025-06-18, ES: 2025-06-20

Condition(s): colorectal carcinoma (CRC)

Source: https://euclinicaltrials.eu/ctis-public/view/2024-519301-36-00